EU clinical trial 2024-514301-62-00: FAPI PET in Pleural Mesothelioma: The Diagnostic Accuracy and Clinical Value of FAPI PET at Diagnosis, Primary Staging, and the Feasibility of FAPI PET for Response Evaluation
Sponsor: Aalborg University Hospital (Hospital/Clinic/Other health care facility). Phase: Therapeutic exploratory (Phase II). Countries: Denmark (ongoing, recruiting).
Therapeutic area(s): Diseases [C] - Neoplasms [C04]; Analytical, Diagnostic and Therapeutic Techniques and Equipment [E] - Diagnosis [E01]
Gender: Female, Male. Age: 18-64 years, 65+ years. Enrolment: 70.
Status: Ongoing, recruiting. Start date (EU): 2025-01-29. Decision date: 2024-10-07. Results received: No. Last updated: 2026-04-17.

Condition(s): Pleural Mesothelioma
Product: 68Ga-FAPI-46, Fluor-18-FDG, 400 MBq-210 GBq, injektionsvreske Fludeoxyglucose (18F)

Primary endpoint: Compare the FAPI PET/CT and FDG PET/CT findings in primary tumor, regional lymph nodes and distant metastases to a histopathological reference standard where the sensitivity, specificity, PPV, and NPV of the PET/CTs are determined at primary staging
Endpoint(s): Calculate the proportion of patients where the location of the intended pleural biopsy is altered due to FAPI PET/CT replacing FDG PET/CT and other imaging modalities’ role in guiding the pleural biopsy. This will be determined at the tentative MDT., Compare the cancer stage (IASCL 8 th edition TNM-classification) as determined by FAPI PET/CT compared to conventional imaging (including FDG PET/CT) at primary staging. The proportion of patients downstaged, unchanged stage, and upstaged, due to the added FAPI PET/CT are determined., Calculate the proportion of patients with suspected PM lesion with a change in treatment following the – hypothetical – addition of FAPI PET/CT at primary staging. The proportion of patients hypothetically treated differently, as deemed by collaborating clinicians participating in the tentative MDT, due to more advanced disease or less advanced disease, are determined., Measure/calculate standardized uptake value (SUV) and tumor to background ratio (TBR) values for pleural PM lesions, regional lymph nodes, and distant metastases for FAPI PET/CT and compare these values to FDG PET, both at primary staging and after 2-3 series of anticancer treatment., Measure/calculate FAPI PET SUV and TBR in benign pleural lesions, as revealed upon histopathology or composite reference standard, and compare these values to those derived from the primary FDG PET., Calculate changes in SUV and TBR in primary, regional lymph nodes, and distant metastases for FAPI PET - from before to after 2-3 series of anticancer treatment and compare these values to the changes in the FDG PET parameters, Measure/calculate MITV (Molecular Imaging Tumor Volume) and VIP (Volume Intensity Product) for both FAPI PET/CT and FDG PET/CT at primary staging and after 2-3 series of anticancer treatment and compare these values between FAPI PET/CT and FDG PET/CT., Calculate changes in MITV and VIP for both FAPI PET/CT and FDG PET/CT from before to after neoadjuvant chemotherapy and compare these values between FAPI PET/CT and FDG PET/CT., Correlate the FAPI PET and FDG PET uptake parameters (SUV, TBR, MITV, VIP) to the subtype of PM (epithelioid, biphasic, sarcomatoid)., A 10 year follow up of included patients will be conducted to determine overall survival (OS), Recurrence Free Survival (RFS) and Progression Free Survival (PFS). These will be compared between FAPI PET/CT based markers (e.g., tentative FAPI PET stage, SUV, TBR, MITV, VIP) and other common clinical practice derived markers (e.g., FDG PET staging, other biomarkers)., Compare conventional CT-based response assessment (mRECIST/iRECIST) to PET based response assessment (PERCIST, and other FDG and FAPI PET derived data) to the clinical outcome, i.e., OS, RFS/PFS., Conduct an interobserver study of FAPI PET/CTs performed in the present and other future FAPI PET/CT cancer studies conducted at Aalborg UH., Seek supplementary information in medical records, biochemistry, pathology, or other imaging modalities for a final diagnosis/condition in cases of unexpected FAPI PET/CT findings., Correlate the FAPI PET SUV to FAP targeting immunohistochemistry. Furthermore, FAP based volumedensity estimations pleural biopsies will be conducted and sought correlated with the FAPI PET SUV., Report potential AEs and ARS related to the [68Ga]Ga-FAPI-46 injection.

Source: https://euclinicaltrials.eu/ctis-public/view/2024-514301-62-00